EU clinical trial 2025-524858-34-00: J3L-MC-EZEJ: A Phase 3, Randomized, Double-Blind, Placebo-Controlled Trial of Lepodisiran to Investigate the Effect on Coronary Plaque in Adults With Elevated Lp(a) Who Have Established Atherosclerotic Cardiovascular Disease or Are at Risk for a First Cardiovascular Event
Protocol code: J3L-MC-EZEJ
Sponsor: Eli Lilly & Co. (Pharmaceutical company). Phase: Therapeutic confirmatory (Phase III). Countries: Hungary (authorised, recruitment pending), Czechia (authorised, recruitment pending), Spain (authorised, recruitment pending), Netherlands (authorised, recruitment pending).
Therapeutic area(s): Diseases [C] - Cardiovascular Diseases [C14]
Gender: Female, Male. Age: 18-64 years. Enrolment: 145.
Status: Authorised, recruitment pending. Decision date: 2026-07-30. Results received: No. Last updated: 2026-08-04.
Decision dates by country: CZ: 2026-07-30, HU: 2026-07-30, ES: 2026-07-31, NL: 2026-08-04

Condition(s): Cardiovascular Diseases, Atherosclerosis, Lipoprotein(a)
Product: Placebo to match LY, Lepodisiran

Primary endpoint: Percent Change from Baseline in Noncalcified Plaque (NCP) Volume

Source: https://euclinicaltrials.eu/ctis-public/view/2025-524858-34-00